EU clinical trial 2023-504687-42-00: A Pilot Open-label, Randomized, Crossover, Comparative Bioavailability Study of Levodopa Administered via Levodopa Cyclops™ (test product) Relative to INBRIJA® (reference product) in Healthy Adult Subjects
Protocol code: CPI23001
Sponsor: CCDRD Cooperative Clinical Drug Research and Development AG, PureIMS B.V. (Pharmaceutical company). Phase: Human Pharmacology (Phase I)- Other. Countries: Bulgaria (ended).
Therapeutic area(s): Diseases [C] - Nervous System Diseases [C10]
Gender: Female, Male. Age: 18-64 years. Enrolment: 26.
Status: Ended. Start date (EU): 2023-09-19. End date (EU): 2023-11-09. Decision date: 2023-08-15. Results received: Yes. Last updated: 2023-08-15.

Condition(s): No therapeutic indication in the current trial with healthy volunteers. The intended indication is for intermittent treatment of episodic motor fluctuations (OFF episodes) in adult patients with Parkinson’s disease (PD) treated with a levodopa/dopa-decarboxylase inhibitor.
Product: Inbrija 33 mg inhalation powder, hard capsules, CARBIDOPA, Levodopa Cyclops™

Primary endpoint: The pharmacokinetic (PK) endpoints in the present trial are Cmax, Tmax, AUC(0-4h), AUC(0-t), AUC(0-∞), t½ of levodopa.
Endpoint(s): The safety endpoints in this trial are the clinical and laboratory examinations and registration of adverse events, clinical biochemistry, hematology, urinalysis, physical examination, vital signs (pre- and post-dose).

Source: https://euclinicaltrials.eu/ctis-public/view/2023-504687-42-00